EU clinical trial 2022-502745-98-00: Octreotide treatment to improve nutritional recovery after surgery for patients with esophageal or gastric cancer, a prospective randomized open label phase II study - OTIS
Sponsor: Karolinska University Hospital (Hospital/Clinic/Other health care facility). Phase: Therapeutic exploratory (Phase II). Countries: Sweden (ended).
Therapeutic area(s): Diseases [C] - Nutritional and Metabolic Diseases [C18]
Gender: Female, Male. Age: 18-64 years, 65+ years. Enrolment: 172.
Status: Ended. Start date (EU): 2020-11-17. End date (EU): 2024-02-21. Decision date: 2022-12-20. Results received: Yes. Last updated: 2022-12-20.

Condition(s): Esophageal and gastric cancer
Product: Sandostatin LAR 10 mg pulver och vätska till injektionsvätska, suspension

Primary endpoint: Weight loss in percent (%) from baseline weight before surgery, measured at 1, 2, 3, and 6 months after surgery (continuously).
Endpoint(s): Measurement of S-GLP-1, S-PYY, S-Ghrelin and S-GIP (prior to octreotide administration), measured at baseline, 7 days (±2 days) post-surgery and after 1 (±4 days), 2(±4 days), 3(±4 days), and 6 (±4 days) months., Body composition measured in percent (%) body fat (continuously) and with the questionnaires PG-SGA and EORTC CAX24., Health-related Quality of Life (HRQOL) measured using EORTC QLQ-C30 and QLQ-OG25, including esophageal cancer specific symptoms, at baseline and at 1, 2, 3 and 6 months after randomization., Percentage (of subjects) in need of enteral nutrition with a jejunostomy feeding catheter or nasogastric tube, Number and type of Adverse Events, including known AEs of Sandostatin LAR depot, such as biliary abnormalities, injection-site pain, nausea, abdominal pain, fatigue, headache, hyperglycemia, back pain, constipation or vomiting, dizziness, sinus bradycardia, pruritus, upper respiratory tract infection, myalgia, flatulence, arthropathy, rash, generalized pain, sinusitis, conduction abnormalities, hypoglycemia, and arrhythmia., Number of patients completing treatment.

Source: https://euclinicaltrials.eu/ctis-public/view/2022-502745-98-00